EU clinical trial 2023-509067-24-01: A Phase 2 Evaluation of the Safety and Efficacy of Veonetinib (AL8326) in ≥2nd Line Small Cell Lung Cancer (SCLC), Non Small Cell Lung Cancer (NSCLC) and Renal Cell Carcinoma (RCC) Treatment
Protocol code: AL8326-US-001
Sponsor: Advenchen Pharmaceuticals LLC (Pharmaceutical company). Phase: Therapeutic exploratory (Phase II). Countries: Spain (ongoing, recruitment ended), Italy (authorised, recruitment pending).
Therapeutic area(s): Diseases [C] - Neoplasms [C04]
Gender: Female, Male. Age: 18-64 years, 65+ years. Enrolment: 50.
Start date (EU): 2026-04-22. Decision date: 2025-02-10. Results received: No. Last updated: 2026-04-17.
Decision dates by country: ES: 2025-02-12, IT: 2025-02-10

Condition(s): - Small Cell Lung Cancer (SCLC) patients who need ≥2nd line treatment without or with brain metastasis which is controlled with no active hemorrhage. - Non Small Cell Lung Cancer (NSCLC) patients who need ≥2nd line treatment with brain metastasis which is controlled with no active hemorrhage. - Renal Cell Carcinoma (RCC) patients who need ≥2nd line treatment., - Small Cell Lung Cancer (SCLC) patients who need ≥2nd line treatment without or with brain metastasis which is controlled with no active hemorrhage. - Non Small Cell Lung Cancer (NSCLC) patients who need ≥2nd line treatment with brain metastasis which is controlled with no active hemorrhage. - Renal Cell Carcinoma (RCC) patients who need ≥2nd line treatment.
Product: AL8326

Primary endpoint: OBD and ORR for all dosing groups and OBD group plus expansion cohort for SCLC cohort. ORR for NSCLC and RCC cohort
Endpoint(s): DOR and PFS for SCLC OBD group plus expansion cohort; NSCLC and RCC cohortgroup; ; Pharmacokinetic endpoints such as Cmax, AUC and other typic PK parameters; and PK/PD/Efficacy/Safety relationship for SCLC.

Source: https://euclinicaltrials.eu/ctis-public/view/2023-509067-24-01